EU clinical trial 2024-518686-10-00: Safety, tolerability and immunogenicity of fractional, intradermal mRNA SARS-CoV-2 vaccination in patients with Fibrodysplasia Ossificans Progressiva (IVY trial)
Protocol code: IVY1
Sponsor: Amsterdam UMC Stichting (Patient organisation/association). Phase: Therapeutic use (Phase IV). Countries: Netherlands (ongoing, recruiting).
Therapeutic area(s): Diseases [C] - Virus Diseases [C02]; Diseases [C] - Musculoskeletal Diseases [C05]
Gender: Female, Male. Age: 18-64 years, 65+ years. Enrolment: 10.
Status: Ongoing, recruiting. Start date (EU): 2025-01-27. Decision date: 2025-01-27. Results received: No. Last updated: 2025-01-27.

Condition(s): Fibrodyplasia Ossificans Progressiva (FOP)
Product: Comirnaty JN.1 30 micrograms/dose dispersion for injection COVID-19 mRNA Vaccine

Primary endpoint: Primary Safety: Nature, frequency and severity of systemic events, including flare-ups, fever, fatigue, headache, chills, vomiting, diarrhea, new or worsened muscle pain, and new or worsened joint pain., Primary Efficacy: SARS-CoV-2 WT neutralising antibody titres rate and SARS-CoV-2-spike protein–specific binding IgG antibody titres rate on day 1, day 29 and day 43
Endpoint(s): Secundary Safety: Nature, frequency and severity of local reactions. Solicited adverse events include: pain, redness and swelling at the injection site and pain and swelling at the regional lymph nodes, Secundary Safety: Use of corticosteroids, antipyretics and painkillers, Secundary Efficacy: B-cell and T-cell responses on day 1, day 29 and day 43

Source: https://euclinicaltrials.eu/ctis-public/view/2024-518686-10-00